EU clinical trial 2024-512722-28-00: Randomized, double-blind, placebo-controlled, two-part study assessing the safety, tolerability and pharmacokinetics of BP1.7881 administered as higher doses, after single ascending doses (Part I) and multiple ascending doses (Part II), including the assessment of BP1.7881 on cardiac repolarization, in healthy subjects.
Protocol code: P22-03
Sponsor: Bioprojet Pharma (Pharmaceutical company). Phase: Human Pharmacology (Phase I)- Other. Countries: Belgium (ongoing, recruiting).
Therapeutic area(s): Diseases [C] - Immune System Diseases [C20]
Gender: Female, Male. Age: 18-64 years. Enrolment: 161.
Status: Ongoing, recruiting. Start date (EU): 2025-04-22. Decision date: 2025-03-07. Results received: No. Last updated: 2026-04-10.

Condition(s): Eosinophilic esophagitis

Source: https://euclinicaltrials.eu/ctis-public/view/2024-512722-28-00